EU clinical trial 2025-522026-13-00: A multicentre, randomised, double-blind, placebo-controlled, parallel-group phase 2a trial to evaluate the efficacy and safety of BP1.4979 in adult participants with obsessive compulsive disorder
Protocol code: P24-05
Sponsor: Bioprojet Pharma (Pharmaceutical company). Phase: Therapeutic exploratory (Phase II). Countries: Portugal (ongoing, recruiting), Spain (ongoing, recruiting), Italy (authorised, recruiting), Poland (ongoing, recruiting).
Therapeutic area(s): Psychiatry and Psychology [F] - Mental Disorders [F03]
Gender: Female, Male. Age: 18-64 years, 65+ years. Enrolment: 54.
Start date (EU): 2026-01-12. Decision date: 2025-12-16. Results received: No. Last updated: 2026-08-04.
Decision dates by country: PT: 2025-12-16, IT: 2025-12-18, PL: 2025-12-22, ES: 2025-12-22

Condition(s): Obsessive compulsive disorder
Product: Matching film-coated placebo tablet

Primary endpoint: The primary efficacy endpoint is the change in the total score on the Yale-Brown ObsessiveCompulsive Scale Second Edition (YBOCS-II) at end of treatment.
Endpoint(s): Change in total score of the YBOCS-II at visits 3 and 4, Change in total score of Obsessive-Compulsive Inventory-Revised (OCI-R) at visits 3, 4 and 5, Change in global functioning responses as assessed on the Clinical Global Impressions – Change (CGI-C) scale, Change in total score of Montgomery and Asberg Depression rating scale (MADRS)

Source: https://euclinicaltrials.eu/ctis-public/view/2025-522026-13-00